EU clinical trial 2024-514739-12-00: Peripheral TMD Pain Mechanisms and the Effect by Botulinum Toxin A
Protocol code: BTXclintrialv1
Sponsor: Karolinska Institutet (Educational Institution). Phase: Therapeutic exploratory (Phase II). Countries: Sweden (ongoing, recruiting).
Therapeutic area(s): Diseases [C] - Musculoskeletal Diseases [C05]
Gender: Female, Male. Age: 18-64 years. Enrolment: 100.
Status: Ongoing, recruiting. Start date (EU): 2024-06-20. Decision date: 2024-06-20. Results received: No. Last updated: 2026-07-21.

Condition(s): Myogenous temporomandibular disorders (TMDM)
Product: BOTULINUM TOXIN

Primary endpoint: The change of gene expressions, epigenetic signatures, and cells plasticity in the masseter muscle
Endpoint(s): The change of jaw muscle pain intensity after treatment

Source: https://euclinicaltrials.eu/ctis-public/view/2024-514739-12-00